EU clinical trial 2025-521682-27-00: Sentinel lymph node (SLN) detection in early oral cancer using Gallium-68-Tilmanocept PET/CT.
Protocol code: V0001699
Sponsor: Universitair Medisch Centrum Utrecht (Hospital/Clinic/Other health care facility). Phase: Phase III and phase IV (Integrated). Countries: Netherlands (suspended).
Therapeutic area(s): Diseases [C] - Neoplasms [C04]; Analytical, Diagnostic and Therapeutic Techniques and Equipment [E] - Investigative Techniques [E05]
Gender: Female, Male. Age: 18-64 years, 65+ years. Enrolment: 94.
Status: Suspended. Decision date: 2025-04-18. Results received: No. Last updated: 2025-04-18.

Condition(s): Oral cancer
Product: TILMANOCEPT, TILMANOCEPT, GALLIUM (68GA) CHLORIDE, TECHNETIUM (99MTC)

Primary endpoint: The sensitivity and negative predictive value of 68Ga-Tilmanocept PET/CT combined with conventional lymphoscintigraphy for SLNB. Furthermore, the sensitivity and negative predictive value for preoperative 68Ga-Tilmanocept PET/CT alone will be compared with conventional preoperative lymphoscintigraphy alone.
Endpoint(s): To compare the number of 68Ga-Tilmanocept PET-CT detected SLNs with those detected by means of 99mTc-Tilmanocept lymphoscintigraphy on a per-subject basis., To compare histopathologic assessment (presence or absence of metastasis) of the excised lymph node(s) detected by conventional preoperative 99mTc-Tilmanocept lymphoscintigraphy and intraoperative gammaprobe localization, with the SLNs identified by means of preoperative 68Ga-Tilmanocept PET-CT., Observing contralateral drainage patterns in lateralized tumors and compare these patterns between of 68Ga-Tilmanocept PET-CT and 99mTc-Tilmanocept lymphoscintigraphy, especially in case of a histopathological positive sentinel node., To assess pairwise inter-observer agreements between 68Ga-Tilmanocept PET-CT and 99mTc-Tilmanocept lymphoscintigraphy regarding preoperative SLN detection.

Source: https://euclinicaltrials.eu/ctis-public/view/2025-521682-27-00